EU clinical trial 2024-513956-14-00: MRD-guided treatment with pembrolizumab and azacitidine in NPM1mut AML patients with an imminent hematological relapse (PEMAZA)
Protocol code: TUD-PEMAZA-068
Sponsor: Technische Universitaet Dresden (Educational Institution). Phase: Therapeutic exploratory (Phase II). Countries: Germany (ended).
Therapeutic area(s): Diseases [C] - Neoplasms [C04]; Diseases [C] - Hemic and Lymphatic Diseases [C15]
Gender: Female, Male. Age: 18-64 years, 65+ years. Enrolment: 28.
Status: Ended. Start date (EU): 2019-09-16. End date (EU): 2025-03-31. Decision date: 2024-10-25. Results received: Yes. Last updated: 2025-04-09.

Condition(s): Acute myeloid leukemia
Product: AZACITIDINE, KEYTRUDA 25 mg/mL concentrate for solution for infusion

Primary endpoint: The primary endpoint of the trial will be proportion of event-free patients after 24 weeks of combination treatment (i.e. after up to 6 cycles of AZA for 7 d Q4W and up to 8 PEM infusions Q3W). Events are defined as: (i) First hematologic relapse after start of combined therapy, (ii) Death from any cause, (iii) AML-treatment other than PEM and AZA or HMA only.
Endpoint(s): Overall survival., Proportion of event-free patients after 12 weeks of combined therapy, Treatment-related mortality during 24 weeks of combined therapy, Course of MRD-burden measured as quantitative NPM1/ABL ratio over time

Source: https://euclinicaltrials.eu/ctis-public/view/2024-513956-14-00